EU clinical trial 2024-515998-94-00: GLORIOUS II: Dexamethasone, olanzapine, flow-targeted versus pressure-targeted hemodynamic management, and low tidal volume ventilation in patients undergoing on-pump cardiac surgery – a multifactorial design randomized trial
Protocol code: 2021-HJEPharma-002
Sponsor: Rigshospitalet (Hospital/Clinic/Other health care facility). Phase: Therapeutic confirmatory (Phase III). Countries: Denmark (ongoing, recruiting).
Therapeutic area(s): Diseases [C] - Cardiovascular Diseases [C14]
Gender: Female, Male. Age: 18-64 years, 65+ years. Enrolment: 1200.
Status: Ongoing, recruiting. Start date (EU): 2022-11-10. Decision date: 2024-10-23. Results received: No. Last updated: 2026-02-27.

Condition(s): We investigate the efficacy of two pharmaceutical interventions for reducing mortality and organ damage, and shortening length of hospital stay in patients undergoing heart surgery (i.e. coronary artery bypass grafting and/or heart valve replacement).
Product: PLACEBO, PLACEBO, Olanzapine Glenmark Europe 20 mg orodispersible tablets, Dexavit, injektions-/infusionsvæske, opløsning

Primary endpoint: The primary endpoint will be number of days alive and outside hospital within 90 days after surgery.
Endpoint(s): Time in days to occurrence of any component in a composite secondary endpoint during follow-up: a) Death from any cause, b) Stroke, c) Acute kidney injury or d) New onset or worsening heart failure, Severe post-operative complications during index admission, defined as a Clavien-Dindo class of 3 to 5., Delirium during the first 7 days after surgery, defined as a positive Confusion Assessment Method for the ICU (CAM-ICU) score or a positive Confusion Assessment Method (CAM) score for the general wards, Quality of Recovery-15 (QoR-15) score 3 days, or as soon as possible, after surgery, 90-day outcomes: Survival, Change in modified Rankin Scale (mRS) from baseline, Health-related quality of life (EQ-5D-5L), Change in self-perceived function "two simple questions" and Days alive outside ICU, 180-day outcomes: Survival

Source: https://euclinicaltrials.eu/ctis-public/view/2024-515998-94-00